EU clinical trial 2023-504909-37-00: A clinical trial to evaluate the long-term safety and durability of efficacy of BI 3720931, an inhaled lentiviral vector gene therapy, after single dose administration in a previous clinical trial in people with cystic fibrosis rolled-over from a previous clinical trial with BI 3720931 (LenticlairTM-ON).
Protocol code: 1504-0003
Sponsor: Boehringer Ingelheim International GmbH, Boehringer Ingelheim Espana S.A. (Pharmaceutical company). Phase: Phase I and Phase II (Integrated)- Other. Countries: Spain (ongoing, recruitment ended), France (ongoing, recruitment ended), Italy (ongoing, recruitment ended), Netherlands (ongoing, recruitment ended).
Therapeutic area(s): Diseases [C] - Respiratory Tract Diseases [C08]
Gender: Female, Male. Age: 18-64 years, 65+ years. Enrolment: 12.
Status: Ongoing, recruitment ended. Start date (EU): 2025-07-03. Decision date: 2024-06-17. Results received: No. Last updated: 2026-08-05.
Decision dates by country: IT: 2024-06-20, FR: 2024-06-17, ES: 2024-06-17, NL: 2024-06-19

Condition(s): Cystic fibrosis
Product: BI 3720931, BI 3720931

Primary endpoint: Occurrence of treatment-emergent delayed AEs defined as new malignancies, new serious neurologic disorders, new serious rheumatologic or autoimmune disorders, new serious hematologic disorders, or new serious potentially product-related infections, until 15 years from enrolment
Endpoint(s): Time to loss of efficacy defined as the drop to below 5% (absolute) above baseline in forced expiratory volume in 1 second, percent of predicted value (FEV1pp), Time to first PEX from dosing, Occurrence of AEs up to 2 years after enrolment, Occurrence of serious adverse events (SAEs) throughout the study (up to 15 years), Occurrence of replication-competent lentivirus (RCL) throughout the study (up to 15 years)

Source: https://euclinicaltrials.eu/ctis-public/view/2023-504909-37-00